EU clinical trial 2024-510648-29-00: Preemptive treatment with venetoclax plus azacitidine in patients diagnosed with acute myeloid leukemia (AML) with persistence or reappearance of measurable residual disease (MRD) after frontline chemotherapy and high-level MRD prior to allogeneic hematopoietic cell transplantation (alloHCT)
Protocol code: CETLAM-LMA-AC-202401
Sponsor: Grupo Cooperativo De Estudio Y Tratamiento De Las Leucemias Agudas Y Mielodisplasias (Laboratory/Research/Testing facility). Phase: Phase II and Phase III (Integrated). Countries: Spain (ongoing, recruitment ended).
Therapeutic area(s): Diseases [C] - Neoplasms [C04]
Gender: Female, Male. Age: 18-64 years, 65+ years. Enrolment: 29.
Status: Ongoing, recruitment ended. Start date (EU): 2024-12-12. Decision date: 2024-08-14. Results received: No. Last updated: 2025-07-21.

Condition(s): Patients diagnosed with acute myeloid leukemia (AML) with persistent measurable residual disease (MRD) or MRD reappearance after frontline chemotherapy, or prior to allogeneic hematopoietic cell transplantation (alloHCT). Patients will be recruited in two independent cohorts depending on the pre-established time point for the intervention and ELN risk subtype: - Cohort 1: Patients diagnosed with a favorable European LeukemiaNet (ELN) subtype AML, not intended for alloHCT in first complete remission (CR1), but who present an MRD failure by after frontline intensive chemotherapy, as defined in the 2021 update on MRD guidelines elaborated by the European LeukemiaNet MRD Working Party (Heuser et al. 2021): ○ In patients with persistent low-level MRD (<2%) after consolidation chemotherapy, an increase of MRD ≥1log10 between 2 positive samples ○ Confirmed MRD conversion of MRD negativity to MRD positivity AML during subsequent follow-up (up to 3 years after chemotherapy completion). - Cohort 2: Patients diagnosed with a non-favorable ELN AML subtype, intended to undergo alloHCT, in first complete morphological remission but harboring detectable MRD at time of alloHCT (>0.1%).
Product: AZACITIDINE, Venclyxto 100 mg film-coated tablets

Primary endpoint: Rate of MRD conversion after 2 to 4 courses of Ven/Aza treatment.
Endpoint(s): Duration of MRD response: The length of time from the first obtention of MRD clearance until MRD progression., Relapse risk after intervention: The length of time from the intervention for AML until confirmed hematological relapse.

Source: https://euclinicaltrials.eu/ctis-public/view/2024-510648-29-00